EU clinical trial 2024-518183-12-00: Efficacy of dalbavancin in osteoarticular infections associated with hip, knee and shoulder prostheses PRO-DALBA
Protocol code: 20-AOI-03
Sponsor: Centre Hospitalier Universitaire De Nice (Hospital/Clinic/Other health care facility). Phase: Therapeutic exploratory (Phase II). Countries: France (ongoing, recruitment ended).
Therapeutic area(s): Diseases [C] - Bacterial Infections and Mycoses [C01]
Gender: Female, Male. Age: 18-64 years, 65+ years. Enrolment: 43.
Status: Ongoing, recruitment ended. Start date (EU): 2022-03-07. Decision date: 2024-10-14. Results received: No. Last updated: 2026-07-22.

Condition(s): prosthetic joint infections
Product: RIFAMPICIN, Xydalba 500 mg powder for concentrate for solution for infusion

Primary endpoint: Success is defined as the absence of failure within 12 months of surgical management.
Endpoint(s): Success is defined as the absence of failure within 24 months of surgical management., Tolerability will be assessed by collecting adverse events during treatment with dalbavancin and rifampicin classified according to CTCAE (version 5.0) within 6 months of first administration., Clinical outcomes at 12 and 24 months will be defined in the same way as for the primary endpoint, in terms of treatment success or failure. Residual dose of dalbavancin at D61, Failure will be defined here in the same way as described for the primary endpoint. The endpoint used will be the proportion of patients achieving success at 12 months (no failure during follow-up). Since the definition of failure in our study was modeled after that of the DATIPO study, there should be no issues regarding the consistency of data collection for this endpoint between the two studies., The time to failure will be defined as the period between the date of surgery and the occurrence of a failure as described above. If the patient has not experienced a failure by the end of follow-up at 12 months, the time to failure will be censored at that date. In the event of death, the time to failure will be censored at that date; if follow-up is discontinued, it will be censored at the date of the last visit.

Source: https://euclinicaltrials.eu/ctis-public/view/2024-518183-12-00